EU clinical trial 2024-520258-39-00: A Phase 1, Open-Label, Dose-escalation Clinical Trial of Tumor Necrosis Factor Alpha and Interleukin-2 Coding Oncolytic Adenovirus (TILT-123) in Patients with Injectable Solid Tumors.
Protocol code: TILT-T115
Sponsor: TILT Biotherapeutics Oy (Pharmaceutical company). Phase: Human Pharmacology (Phase I)- Other. Countries: Finland (authorised, recruitment pending).
Therapeutic area(s): Diseases [C] - Neoplasms [C04]
Gender: Female, Male. Age: 18-64 years, 65+ years. Enrolment: 39.
Status: Authorised, recruitment pending. Decision date: 2024-12-20. Results received: No. Last updated: 2024-12-20.

Condition(s): Solid Tumors

Source: https://euclinicaltrials.eu/ctis-public/view/2024-520258-39-00